EU clinical trial 2025-522626-12-00: Bioequivalence of Mirabegron 50 mg Prolonged-Release Tablets in Healthy Participants Under Fasting Conditions.
Protocol code: CFA-1048-2-25
Sponsor: Laboratorios Cinfa S.A. (Pharmaceutical company). Phase: Human Pharmacology (Phase I)- Bioequivalence Study. Countries: Portugal (ended).
Therapeutic area(s): Not possible to specify
Gender: Female, Male. Age: 18-64 years. Enrolment: 54.
Status: Ended. Start date (EU): 2025-12-18. End date (EU): 2026-03-06. Decision date: 2025-11-17. Results received: No. Last updated: 2026-01-28.

Condition(s): No medical condition.

Source: https://euclinicaltrials.eu/ctis-public/view/2025-522626-12-00